EU clinical trial 2023-509054-54-00: A Study to Learn How Different Amounts of the Study Medicine Called PF-07328948 are Tolerated and Act in the Body in Healthy Adults
Protocol code: C4921002
Sponsor: Pfizer Inc. (Pharmaceutical company). Phase: Human Pharmacology (Phase I)- Other. Countries: Belgium (ended).
Therapeutic area(s): Diseases [C] - Musculoskeletal Diseases [C05]
Gender: Female, Male. Age: 18-64 years, 65+ years. Enrolment: 24.
Status: Ended. Start date (EU): 2024-03-19. End date (EU): 2024-06-27. End date: 2024-07-10. Decision date: 2024-03-15. Results received: No. Last updated: 2024-04-18.

Condition(s): Heart failure

Source: https://euclinicaltrials.eu/ctis-public/view/2023-509054-54-00